EU clinical trial 2024-519808-27-00: Application of antiCD19 CAR T lymphocytes for the treatment of adult patients with B-cell acute lymphoblastic leukemia with resistance, relapse or detectable measurable residual disease. Phase I/II clinical trial (MERMAID1)
Protocol code: MERMAID1
Sponsor: Medical University Of Warsaw (Educational Institution). Phase: Phase I and Phase II (Integrated)- First administration to humans. Countries: Poland (temporarily halted).
Therapeutic area(s): Diseases [C] - Neoplasms [C04]
Gender: Female, Male. Age: 18-64 years, 65+ years. Enrolment: 20.
Status: Temporarily halted. Start date (EU): 2023-12-19. Decision date: 2025-01-30. Results received: No. Last updated: 2025-03-13.

Condition(s): B-cell acute lymphoblastic leukemia. with resistance, relapse or detectable measurable residual disease
Product: FCTX-CL19-1

Primary endpoint: Overall response rate (ORR) to treatment, defined as complete remission (CR) and complete remission with incomplete haematopoietic recovery (CRi), Percentage of patients with treatment-emergent adverse event (TEAE) Grade ≥ 3 within 12 weeks after treatment of therapies of particular interest, i.e.: o Cytokine Release Syndrome (CRS)o Neurological Adverse Events (ICANS) o Infections o Febrile neutropenia o Persistent cytopenias (i.e. more than 28 days after CAR T cell administration) o Tumor lysis syndrome (TLS)
Endpoint(s): Percentage of patients with SAE during the observation period, taking into account their severity and the causal relationship with the applied treatment, Disease-free percentage at 1, 3, 6, 12, 18 and 24 months post-infusion ie complete remission (CR) or complete remission with incomplete haematopoietic recovery (CRi) with negative minimal residual disease (MRD-) cytometrically assessed, Progression-Free Survival (PFS); Time from CAR-T infusion to relapse or death from any cause, Overall Survival (OS); Time from CAR-T infusion to death from any cause, Cmax; cellular kinetics of CAR-T - maximum expression observed in peripheral blood after a single administration (% copies/µg) over 24 months of observation, Tmax; CAR-T cellular kinetics - time to maximum copy number in peripheral blood after a single administration (days) over 24 months of observation, AUC0-30d and 90d; CAR-T cellular kinetics - AUC from day 0 to day 30 and 90 or other days as assessed in peripheral blood (% copies/µg x days), AUC0-Tmax; CAR-T cellular kinetics - AUC from day 0 to Tmax in peripheral blood (% copies/µg/days), Percentage of patients enrolled in the study for whom the CAR-T product was manufactured, Duration of response (time from finding CR or CRi to patient progression or death from any cause), Percentage of CR or CRi patients with persistent B-cell aplasia after CAR-T cell infusion over 24 months of follow-up. Absolute CD19(+) lymphocyte count < 50/µl

Source: https://euclinicaltrials.eu/ctis-public/view/2024-519808-27-00